EU clinical trial 2024-516408-40-00: Study of the benefit of lenvatinib treatment in waiting list of liver transplantation after TACE failure in patients with hepatocellular carcinoma (HCC) : Ta-Len-Tra
Protocol code: APHP220267
Sponsor: Assistance Publique Hopitaux De Paris (Hospital/Clinic/Other health care facility). Phase: Phase I and Phase II (Integrated)- Other. Countries: France (ended).
Therapeutic area(s): Diseases [C] - Neoplasms [C04]
Gender: Female, Male. Age: 18-64 years, 65+ years. Enrolment: 25.
Status: Ended. Start date (EU): 2024-10-14. End date (EU): 2024-10-15. Decision date: 2024-10-14. Results received: No. Last updated: 2024-10-14.

Condition(s): Non-resectable hepatocellular carcinoma (HCC)
Product: LENVIMA 4 mg hard capsules

Primary endpoint: The proportion of patients with TACE failure and treated with lenvatinib who have a LT
Endpoint(s): Time to progression under lenvatinib before LT by imaging. Progression will be based on RECIST and mRECIST., Progression under lenvatinib before LT by imaging. Progression will be based on RECIST and mRECIST., Response rate before LT by imaging, Response rate by liver specimen pathology after the LT, Recurrence rate after LT by imaging, Evaluate Safety by AE and SAE (using current CTCAE), The endpoints associated to the immunophenotyping of peripheral blood immune cell population will be on the ancillary analyses.

Source: https://euclinicaltrials.eu/ctis-public/view/2024-516408-40-00